EU clinical trial 2023-505277-32-00: A Phase 3, Randomized, Open-Label Study to Evaluate Safety and Efficacy of Epcoritamab in Combination with R-CHOP Compared to R-CHOP in Subjects with Newly Diagnosed Diffuse Large B-Cell Lymphoma (DLBCL) (EPCORE DLBCL-2)
Protocol code: M20-621
Sponsor: AbbVie Deutschland GmbH & Co. KG (Pharmaceutical company). Phase: Therapeutic confirmatory (Phase III). Countries: Spain (ongoing, recruitment ended), Belgium (ongoing, recruitment ended), Bulgaria (ongoing, recruitment ended), Greece (ongoing, recruitment ended), Denmark (ongoing, recruitment ended), Slovakia (ended), Italy (ongoing, recruitment ended), Croatia (ongoing, recruitment ended), Sweden (ongoing, recruitment ended), Austria (ongoing, recruitment ended), Netherlands (ongoing, recruitment ended), Poland (ongoing, recruitment ended), Hungary (ongoing, recruitment ended), Portugal (ongoing, recruitment ended), Czechia (ongoing, recruitment ended), France (ongoing, recruitment ended).
Therapeutic area(s): Diseases [C] - Neoplasms [C04]
Gender: Female, Male. Age: 18-64 years, 65+ years. Enrolment: 435.
Start date (EU): 2023-01-26. Decision date: 2024-04-08. Results received: No. Last updated: 2026-07-13.
Decision dates by country: SK: 2024-04-09, CZ: 2024-04-10, IT: 2024-04-30, PT: 2024-04-09, SE: 2024-04-09, ES: 2024-04-09, HR: 2024-04-09, BE: 2024-05-07, HU: 2024-04-09, GR: 2024-05-20, PL: 2024-04-12, DK: 2024-04-09, FR: 2024-04-11, AT: 2024-04-15, BG: 2024-05-10, NL: 2024-04-08

Condition(s): Diffuse Large B-Cell Lymphoma (DLBCL)
Product: Truxima 500 mg concentrate for solution for infusion, Epcoritamab (GEN3013), Cyclophosphamide Injection 500 mg., Epcoritamab (GEN3013), Doxorubicinhydrochlorid Bendalis 2 mg/ml Injektionslösung, Prednisone Zentiva 5 mg compresse, Vincristine Sulfate 1 mg/ml solution for injection, Truxima 100 mg concentrate for solution for infusion

Primary endpoint: The primary endpoint is PFS defined as the duration from the date of randomization to the date of any of the following (whichever occurs first). The primary analysis population is the subset of subjects with an IPI of 3-5, Death due to any causes., Disease progression based on the independent review committee (IRC) assessment per Lugano criteria.
Endpoint(s): PFS in all randomized subjects., CR on or after the EOT based on the IRC assessment per Lugano criteria, where EOT is defined as treatment completion or early treatment discontinuation., OS, defined as time from randomization until death due to any causes., MRD negativity.

Source: https://euclinicaltrials.eu/ctis-public/view/2023-505277-32-00